EU clinical trial 2026-525611-13-00: Treatment strategies for juvenile idiopathic arthritis patients with sustained inactive disease: A phase 4, multicentre, randomised trial comparing maintenance versus tapered TNF alpha inhibitor monotherapy - the Treat-JIA trial
Protocol code: The Treat-JIA trial
Sponsor: Oslo Universitetssykehus HF (Hospital/Clinic/Other health care facility). Phase: Therapeutic use (Phase IV). Countries: Norway (authorised, recruitment pending).
Therapeutic area(s): Diseases [C] - Musculoskeletal Diseases [C05]; Diseases [C] - Immune System Diseases [C20]
Gender: Female, Male. Age: 0-17 years. Enrolment: 90.
Status: Authorised, recruitment pending. Decision date: 2026-06-23. Results received: No. Last updated: 2026-06-23.

Condition(s): Juvenil Idiopatic Arthritis
Product: Simponi 50 mg solution for injection in pre-filled syringe., Benepali 50 mg solution for injection in pre-filled pen, Hyrimoz 20 mg solution for injection in pre-filled syringe, Hyrimoz 40 mg solution for injection in pre-filled syringe, Enbrel 25 mg solution for injection in pre-filled pen

Primary endpoint: The primary outcome of this study is the proportion of study participants with a disease flare* during the first 12 months follow-up compared between the TNFi withdrawal group and the stable treatment group. *Disease flare is defined as a combination of: A clinically significant increase in JIA Activity Score 27 (JADAS-27) ≥1.7 from baseline AND active joints ≥1 (swollen, or tender + limited range of motion) OR consensus between treating physician and participant/parents
Endpoint(s): Time to flare and time to regain inactive disease after flaring up to 12 months, Changes in validated measures of disease activity up to 12 months, Reports of adverse events, serious adverse events, and suspected unexpected adverse reactions up to 12 months

Source: https://euclinicaltrials.eu/ctis-public/view/2026-525611-13-00